EU clinical trial 2024-513970-23-00: A Multicenter, Open-Label, Phase 2 Study to Investigate the Efficacy and Safety of Sonrotoclax Combined With Zanubrutinib Compared With Zanubrutinib Monotherapy in Adult Patients With Previously Untreated Chronic Lymphocytic Leukemia
Protocol code: BGB-11417-204
Sponsor: BeOne Medicines AG (Pharmaceutical company). Phase: Therapeutic exploratory (Phase II). Countries: Italy (ongoing, recruitment ended), Poland (ongoing, recruitment ended), Spain (ongoing, recruitment ended).
Therapeutic area(s): Diseases [C] - Neoplasms [C04]
Gender: Female, Male. Age: 18-64 years, 65+ years. Enrolment: 39.
Status: Ongoing, recruitment ended. Start date (EU): 2025-02-27. Decision date: 2025-02-04. Results received: No. Last updated: 2026-04-24.
Decision dates by country: IT: 2025-02-05, ES: 2025-02-06, PL: 2025-02-10

Condition(s): Previously Untreated Chronic Lymphocytic Leukemia
Product: BGB-11417, Zanubrutinib, BGB-11417, BGB-11417, BGB-11417

Primary endpoint: Best CR/CRi rate up to the first Post-Treatment Follow-up (PTFU1) Visit for Arm A and up to the C16D1 Visit for Arm B per Independent Review Committee (IRC) response assessment using the 2018 International Workshop on Chronic Lymphocytic Leukemia (Hallek et al 2018) guidelines with modification for treatment-related lymphocytosis (Cheson et al 2012) for patients with CLL
Endpoint(s): uMRD4 rate measured in both peripheral blood and bone marrow aspirate at PTFU 1 Visit for Arm A and at C16D1 Visit for Arm B based on next-generation sequencing (NGS) (clonoSEQ®), • CR/CRi rate per investigator response assessment • ORR per IRC and investigator response assessment • Landmark DOR event-free rate at 12 months per IRC response assessment • DOR per investigator response assessment • TTR per IRC and investigator response assessment • Landmark PFS rate at 24 months and overall PFS per investigator response assessment • OS, Safety will be assessed by monitoring and recording of all treatment emergent adverse events (AEs) graded by National Cancer Institute-Common Terminology Criteria for Adverse Events (NCI-CTCAE) v5.0 and the iwCLL Grading Scale for Hematologic Toxicities in CLL Studies as appropriate. Tumor lysis syndrome (TLS) will be monitored per Howard criteria.

Source: https://euclinicaltrials.eu/ctis-public/view/2024-513970-23-00